EU clinical trial 2022-501528-58-00: ROSY-T: Roll Over StudY for Patients Who Have Completed a Previous Oncology Study with Osimertinib (TAGRISSO) and are Judged by the Investigator to Clinically Benefit From Continued Treatment
Protocol code: D5161N00007
Sponsor: Astrazeneca AB (Pharmaceutical company). Phase: Therapeutic confirmatory (Phase III). Countries: France (ongoing, recruiting), Poland (ongoing, recruiting).
Therapeutic area(s): Diseases [C] - Neoplasms [C04]
Gender: Female, Male. Age: 18-64 years, 65+ years. Enrolment: 2.
Status: Ongoing, recruiting. Start date (EU): 2023-10-16. Decision date: 2023-08-09. Results received: No. Last updated: 2025-11-13.
Decision dates by country: FR: 2023-08-09, PL: 2023-08-14

Condition(s): Various tumor types depending on the parent study
Product: TAGRISSO 80 mg film-coated tablets, TAGRISSO 40 mg film-coated tablets

Primary endpoint: SAEs and serious AESIs reported until 28 days after the last dose of study treatment

Source: https://euclinicaltrials.eu/ctis-public/view/2022-501528-58-00